EU clinical trial 2023-509380-24-00: Anti-PD-1, Capecitabine, and Oxaliplatin for the first-line treatment of dMMR esophagogastric cancer (AuspiCiOus-dMMR): a proof-of-principle study
Sponsor: Amsterdam UMC (Hospital/Clinic/Other health care facility). Phase: Therapeutic exploratory (Phase II). Countries: Netherlands (ongoing, recruitment ended).
Therapeutic area(s): Diseases [C] - Neoplasms [C04]
Gender: Female, Male. Age: 18-64 years, 65+ years. Enrolment: 25.
Status: Ongoing, recruitment ended. Start date (EU): 2021-11-01. Decision date: 2024-04-03. Results received: No. Last updated: 2024-04-03.

Condition(s): Metastatic upper gastrointestinal cancer, cancer of esophagus and stomach
Product: Retifanlimab (INCMGA00012)

Primary endpoint: Interferon gamma (IFN-ϒ) expression and number of infiltrating cytotoxic T-cells
Endpoint(s): - Overall survival - Progression-free survival - Response rate according to RECIST 1.1 or iRECIST - Adverse events according to NCI CTCAE version 5.0. - Quality of life - Percentage of patients proceeding to subsequent lines of treatment after progression and describe the types of subsequent treatments - Reasons for forgoing subsequent treatment after progression

Source: https://euclinicaltrials.eu/ctis-public/view/2023-509380-24-00